EU clinical trial 2024-512248-47-00: Protocol Title: KEYMAKER-U01 Substudy 01F: A Phase 1b/2 Umbrella Study With Rolling Arms of Investigational Agents for Previously Treated of Participants With Advanced or Metastatic Nonsquamous Non-small Cell Lung Cancer (NSCLC) With KRAS G12C Mutations
Protocol code: MK-3475-01F
Sponsor: Merck Sharp & Dohme LLC (Pharmaceutical company). Phase: Phase I and Phase II (Integrated)- Other. Countries: Italy (authorised, recruiting), Germany (ongoing, recruiting), Greece (ongoing, recruiting), Poland (authorised, recruitment pending), Hungary (authorised, recruitment pending), Spain (ongoing, recruiting).
Therapeutic area(s): Diseases [C] - Neoplasms [C04]
Gender: Female, Male. Age: 18-64 years, 65+ years. Enrolment: 57.
Start date (EU): 2026-04-15. Decision date: 2026-03-04. Results received: No. Last updated: 2026-07-24.
Decision dates by country: HU: 2026-03-09, IT: 2026-03-04, PL: 2026-03-07, GR: 2026-03-09, ES: 2026-03-05, DE: 2026-03-05

Condition(s): Non-small Cell Lung Cancer (NSCLC)
Product: CETUXIMAB, MK-2870, MK-1084, MK-1084, MK-1022, MK-1084, MK-1084

Primary endpoint: Number of Participants Who Experience a Dose Limiting Toxicity (DLT), Number of Participants Who Experience an Adverse Event (AE), Number of Participants Who Discontinue Study Treatment Due to an AE, Objective Response Rate (ORR)
Endpoint(s): Duration of Response (DOR), Progression-Free Survival (PFS), Area Under the Curve From Time 0 to the End of the Dosing Interval (AUC tau), Maximum Plasma Concentration (Cmax), Minimum Observed Concentration (Ctrough)

Source: https://euclinicaltrials.eu/ctis-public/view/2024-512248-47-00